EU clinical trial 2024-516476-15-00: A Master Protocol for the Multi-Cohort, Phase 1/2 Study of DCC-3116 in Combination With Anticancer Therapies in Participants With Advanced Malignancies
Protocol code: DCC-3116-01-002
Sponsor: Deciphera Pharmaceuticals Inc. (Pharmaceutical company). Phase: Phase I and Phase II (Integrated)- Other. Countries: Portugal (ongoing, recruiting), Netherlands (ongoing, recruiting), Denmark (authorised, recruiting), Spain (ongoing, recruiting), Italy (ongoing, recruiting), Germany (authorised, recruiting), France (ongoing, recruiting), Greece (authorised, recruitment pending).
Therapeutic area(s): Diseases [C] - Neoplasms [C04]
Gender: Female, Male. Age: 18-64 years, 65+ years. Enrolment: 87.
Start date (EU): 2026-03-04. Decision date: 2025-04-14. Results received: No. Last updated: 2026-08-04.
Decision dates by country: DE: 2025-04-15, DK: 2025-04-14, NL: 2025-04-17, PT: 2025-04-15, FR: 2025-04-17, GR: 2025-04-15, IT: 2025-04-14, ES: 2025-04-15

Condition(s): Advanced gastrointestinal stromal tumor (GIST)
Product: QINLOCK 50 mg tablets

Primary endpoint: Efficacy: ORR based on Investigator assessment, which is defined as the proportion of participants with a best overall response of confirmed CR or confirmed PR per the mRECIST
Endpoint(s): Efficacy: DOR, DCR at 16, 24, and 32 weeks, Time to response, PFS, OS., Safety: TEAEs, SAEs, TEAEs leading to dose reduction, interruption, or discontinuation of any/all study drug(s)., Pharmacokinetics: PK endpoints will be evaluated for DCC-3116, ripretinib, and DP-5439. These PK parameters, if determinable, may include tmax, Cmax, Cmin, AUC.

Source: https://euclinicaltrials.eu/ctis-public/view/2024-516476-15-00